EU clinical trial 2026-525836-41-00: Bioequivalence of Tramadol retard 200 mg Prolonged-Release Tablets in Healthy Participants Under Fasting Conditions
Protocol code: CFA-1049-2-25
Sponsor: Laboratorios Cinfa S.A. (Pharmaceutical company). Phase: Human Pharmacology (Phase I)- Bioequivalence Study. Countries: Czechia (authorised, recruitment pending).
Therapeutic area(s): Diseases [C] - Nervous System Diseases [C10]
Gender: Female, Male. Age: 18-64 years. Enrolment: 36.
Status: Authorised, recruitment pending. Decision date: 2026-07-30. Results received: No. Last updated: 2026-07-30.

Condition(s): Not applicable (submitted trial is a bioavailability trial in healthy participants).

Source: https://euclinicaltrials.eu/ctis-public/view/2026-525836-41-00